EU clinical trial 2024-514038-19-00: The effects of the manipulation of 5-HT, DA and NA on exercise-induced fatigue and brain activation
Sponsor: Vrije Universiteit Brussel (Educational Institution). Phase: Phase III and phase IV (Integrated). Countries: Belgium (ended).
Therapeutic area(s): Not possible to specify
Gender: Female, Male. Age: 18-64 years. Enrolment: 59.
Status: Ended. Start date (EU): 2025-09-15. End date (EU): 2026-01-10. Decision date: 2024-08-29. Results received: No. Last updated: 2024-08-29.

Product: Edronax 4 mg Tabletten, Rilatine Modified Release 10 mg Hartkapseln mit veränderter Wirkstofffreisetzung, P-Tabletten weiß 7 mm Lichtenstein

Primary endpoint: Physiological changes during the onset and impact of fatigue under influence of elevated brain neurotransmitters, Behavioral changes during the onset and impact of fatigue under influence of elevated brain neurotransmitters, Subjective changes during the onset and impact of fatigue under influence of elevated brain neurotransmitters

Source: https://euclinicaltrials.eu/ctis-public/view/2024-514038-19-00